EU clinical trial 2024-519562-48-00: Desferal administration to improve the impaired reaction to hypoxia in diabetes (DESIRED) - A randomised, double-blind, placebo-controlled, cross-over study.
Protocol code: DESIRED
Sponsor: Karolinska University Hospital (Hospital/Clinic/Other health care facility). Phase: Therapeutic exploratory (Phase II). Countries: Sweden (ongoing, recruiting).
Therapeutic area(s): Diseases [C] - Nutritional and Metabolic Diseases [C18]
Gender: Female, Male. Age: 18-64 years. Enrolment: 30.
Status: Ongoing, recruiting. Start date (EU): 2017-01-12. Decision date: 2025-01-13. Results received: No. Last updated: 2025-01-13.

Condition(s): The study will investigate the effect of deferoxamine on the impaired reaction to hypoxia in patients with diabetes mellitus type 1.
Product: Desferal 500 mg pulver till injektions-/infusionsvätska, lösning, Sodium chloride solution for infusion

Primary endpoint: Number of Endothelial Precursor Cells in 10 ml blood after intermittent hypoxia exposure
Endpoint(s): Changes in the levels of angiogenetic chemokines (SDF-1, EPO, VEGF), Changes in the levels of angiogenetic and hypoxic induced genes (VEGFA, SDF-1, BPNP3, GLUT3, PDK1), Changes in electrophysiological parameters important for the cardiorespiratory response: R-R interval change, the standard deviation of the R-R interval, systolic and diastolic blood pressure, end-tidal carbon dioxide, arterial oxygen saturation, breathing rate, tidal volume, minute ventilation and the ratio between Vt and inspiration time (Vt/Ti), baroreflex sensitivity, arterial function parameters: pulse wave velocity, augmentation index, augmentation index corrected for heart rate (AI75)

Source: https://euclinicaltrials.eu/ctis-public/view/2024-519562-48-00